EU clinical trial 2024-512466-34-00: Bevacizumab for the treatment of cerebral RAdiation Induced NecrosiS (BRAINS) study: A multicenter, open-label, randomized clinical trial to assess the clinical efficacy and cost-effectiveness of bevacizumab versus corticosteroids as first-line treatment in patients with symptomatic cerebral radiation necrosis after radiation for high grade glioma or brain metastases
Sponsor: Het Nederlands Kanker Instituut-Antoni van Leeuwenhoek Ziekenhuis Stichting (Hospital/Clinic/Other health care facility). Phase: Therapeutic confirmatory (Phase III). Countries: Netherlands (ongoing, recruiting).
Therapeutic area(s): Diseases [C] - Neoplasms [C04]; Diseases [C] - Nervous System Diseases [C10]; Analytical, Diagnostic and Therapeutic Techniques and Equipment [E] - Therapeutics [E02]
Gender: Female, Male. Age: 18-64 years, 65+ years. Enrolment: 408.
Status: Ongoing, recruiting. Start date (EU): 2025-07-10. Decision date: 2025-02-18. Results received: No. Last updated: 2026-03-13.

Condition(s): High grade glioma (HGG), Brain metastases (BM)
Product: BEVACIZUMAB, DEXAMETHASONE

Primary endpoint: a favourable clinical response, which is defined as (a) utilization of 1.5mg/day or less dexamethasone and (b) meeting one of the following two criteria: 1) improved Karnofsky Performance Status (KPS) (≥ 10 points ) + at least stable Neurologic Assessment in Neuro-Oncology (NANO) or 2) improved NANO (≥ 2 points) + at least stable KPS, assessed 12 weeks after initiation of treatment or 3) an improved KPS (of ≥ 10 points ) + improved NANO (of ≥ 2 points)
Endpoint(s): improvement of ≥10 points for BM and ≥5 points (based on anchor based minimally important differences) for glioma on the EORTC QLQ C30 physical functioning (and other clinically relevant functioning and symptom scales) at 12 weeks, reduction of cerebral edema on T2/Fluid Attenuated Inversion Recovery (FLAIR) and contrast-enhancing lesion on Based on CCMO protocol template CTR Version 3.0, May 2023 14 of 103 T1 MRI at 12 weeks, change in cognitive functioning measured by the Amsterdam Cognition Scan (ACS) at 12 weeks, experienced epileptic seizure frequency and antiseizure medication use at 12 weeks, number of treatment related adverse events until 21 days post end of treatment, 2-year sCRN recurrence free survival, time to next anti-CRN treatment, 2-year progression free survival, 2-year overall survival, the cost-effectiveness of both treatments, the number of patients who reached the main endpoint between 2 and 4 cycles of bevacizumab

Source: https://euclinicaltrials.eu/ctis-public/view/2024-512466-34-00